EU clinical trial 2023-505972-32-00: PRODIGE 85 (FFCD 1804) – KANALRAD Prospective randomized phase III study evaluating induction chemotherapy (modified DCF 4 cycles) followed by chemoradiotherapy compared to standard chemoradiotherapy for locally advanced anal squamous cell carcinoma (T3-4 or N1a, b or c)
Protocol code: PRODIGE85-KANALRAD
Sponsor: Fondation Franc.Cancerologie Digestive (Hospital/Clinic/Other health care facility). Phase: Therapeutic confirmatory (Phase III). Countries: France (ongoing, recruitment ended).
Therapeutic area(s): Diseases [C] - Digestive System Diseases [C06]
Gender: Female, Male. Age: 18-64 years, 65+ years. Enrolment: 310.
Status: Ongoing, recruitment ended. Start date (EU): 2024-02-26. Decision date: 2024-01-15. Results received: No. Last updated: 2026-01-23.

Condition(s): locally advanced anal squamous cell carcinoma
Product: CISPLATIN, FLUOROURACIL, MITOMYCIN, CAPECITABINE, CAPECITABINE, DOCETAXEL

Primary endpoint: Disease-related event free survival (DFS) will be defined as the time between the date of randomization and the date of the first event (residual tumor at 6 months requiring an APR, progression, recurrence (local or metastatic) or death) or date of last news if the patient is alive without any event.
Endpoint(s): Overall survival (OS), Colostomy-free survival (CFS), toxicities and grades according to International Common Terminology Criteria for Adverse Events (CTCAE) version 4.0, Response rate will be evaluated by mRECIST criteria 1.1 and clinical examination, Quality of life scores, Pelvic reccurence rate at 2 years, Metastatic reccurence rate at 2 years

Source: https://euclinicaltrials.eu/ctis-public/view/2023-505972-32-00